EU clinical trial 2025-520540-15-00: Complement Inhibition: Attacking the Overshooting Inflammation @fter Subarachnoid Hemorrhage - A phase II trial on the safety and efficacy of C1 esterase inhibitor for the acute management of subarachnoid hemorrhage
Sponsor: Haaglanden Medisch Centrum Stichting (Hospital/Clinic/Other health care facility). Phase: Therapeutic exploratory (Phase II). Countries: Netherlands (ongoing, recruiting).
Therapeutic area(s): Diseases [C] - Nervous System Diseases [C10]
Gender: Female, Male. Age: 18-64 years, 65+ years. Enrolment: 128.
Status: Ongoing, recruiting. Start date (EU): 2025-01-27. Decision date: 2025-01-27. Results received: No. Last updated: 2026-02-01.

Condition(s): aneurysmal subarachnoid hemorrhage
Product: Sodium Chloride 0.9% w/v Intravenous Infusion BP Solution for Infusion., Cinryze 500 IU powder and solvent for solution for injection

Primary endpoint: Number of participants with delayed cerebral ischemia (DCI). Defined as either a new focal neurological impariment, or a decrease of at least 2 points on the Glasgow Coma Scale. This should last for at least 1 hour, is not apparent immediately after aneurysm occlusion, and cannot be attributed to other causes bij means of clinical assessment, CT or MRI scanning of the brain, and appropriate laboratory studies, Number of participants with complications during hospitalization
Endpoint(s): Cerebral infarction on brain CT at 14 days, Mortality, Daily neurological condition measured bij GCS during the first 14 days, Complement activity in serum and CSF, Coagulation cascade activation, ICU length of stay, Ventilator days

Source: https://euclinicaltrials.eu/ctis-public/view/2025-520540-15-00